EU clinical trial 2023-507280-18-00: J2A-MC-GZGW: A Phase 3, Randomized, Double-Blind Study to Investigate the Efficacy and Safety of Once Daily Oral Orforglipron Compared with Placebo in Adult Participants with Type 2 Diabetes and Inadequate Glycemic Control with Insulin Glargine, with or without Metformin and/or SGLT-2 Inhibitor (ACHIEVE-5)
Protocol code: J2A-MC-GZGW
Sponsor: Eli Lilly & Co. (Pharmaceutical company). Phase: Therapeutic confirmatory (Phase III). Countries: Romania (ended).
Therapeutic area(s): Diseases [C] - Nutritional and Metabolic Diseases [C18]
Gender: Female, Male. Age: 18-64 years, 65+ years. Enrolment: 156.
Status: Ended. Start date (EU): 2024-02-23. End date (EU): 2025-09-09. End date: 2025-09-15. Decision date: 2024-02-19. Results received: No. Last updated: 2025-06-18.
Decision dates by country: RO: 2024-05-08

Condition(s): Type 2 Diabetes
Product: EMPAGLIFLOZIN, DAPAGLIFLOZIN, INSULIN GLARGINE, Placebo to match LY3502970, METFORMIN

Primary endpoint: To demonstrate that orforglipron is superior to placebo in glycemic control.

Source: https://euclinicaltrials.eu/ctis-public/view/2023-507280-18-00